EU clinical trial 2025-521441-24-00: A Phase I/II, Open-Label, Multicenter Study of ALE.P03 (Claudin-1 Targeted Antibody-Drug Conjugate) as a Monotherapy in Adult Patients with Selected Advanced or Metastatic CLDN1+ Solid Tumors
Protocol code: ALE.P03.01
Sponsor: Alentis Therapeutics AG (Pharmaceutical company). Phase: Phase I and Phase II (Integrated)- First administration to humans. Countries: Spain (ongoing, recruiting), France (ongoing, recruiting), Netherlands (ongoing, recruiting), Italy (authorised, recruiting).
Therapeutic area(s): Diseases [C] - Neoplasms [C04]
Gender: Female, Male. Age: 18-64 years, 65+ years. Enrolment: 77.
Start date (EU): 2026-01-19. Decision date: 2025-11-12. Results received: No. Last updated: 2026-08-05.
Decision dates by country: ES: 2025-11-17, FR: 2025-11-13, IT: 2025-11-13, NL: 2025-11-12

Condition(s): Advanced or Metastatic Solid Tumors
Product: ALE.P03

Primary endpoint: Phase 1: Incidence of DLTs, Phase 1: Incidence and severity of AEs and SAEs, Phase 1: Clinically significant changes in laboratory values, vital signs, and ECGs, Phase 1: Tolerability: dose interruptions and dose intensity, Phase 1: Preliminary efficacy parameters per RECIST 1.1 (see protocol for further details): o ORR (defined as CR rate + PR rate) o DoR Note: CLDN1 expression and tumor type subgroup analyses may be performed for these endpoints., Phase 2: Efficacy parameters per RECIST 1.1*: • ORR • DoR Note: CLDN1 expression and tumor type subgroup analyses may be performed for these endpoints.
Endpoint(s): Incidence and severity of AEs and SAEs, Clinically significant changes in laboratory values, vital signs, and ECGs, Tolerability: dose interruptions and dose intensity, DCR per RECIST 1.1 (see protocol for further details), Median PFS (and rate at 6 and 12 months) per RECIST 1.1 (see protocol for further details), Median OS and rate of 6-, 12-, and 24-month survival Note: CLDN1 expression and tumor type subgroup analyses may be performed for these endpoints., PK: • Plasma concentration of ALE.P03 ADC (including total antibody, conjugated exatecan, and free payload exatecan) by cohort PK parameters including, but not limited to, AUCtau, AUClast, AUC0-inf, Cmax, Cmin, Ctrough, Kel, t½, tmax, Cavg, and other parameters as appropriate for total antibody, conjugated exatecan, and free payload exatecan for each dose level and cycle as supported by available data, Immunogenicity: • Presence of anti-ALE.P03 antibodies with screening and confirmatory assay, as appropriate • Proportion of patients categorized by ADA status (ADA positive/negative) following confirmatory assay

Source: https://euclinicaltrials.eu/ctis-public/view/2025-521441-24-00